EU clinical trial 2024-515151-38-00: A PHASE I, RANDOMIZED, DOUBLE-BLIND, PLACEBO-CONTROLLED, DOSE ASCENDING, SINGLE-DOSE STUDY TO EVALUATE SAFETY, TOLERABILITY, PHARMACOKINETICS, PHARMACODYNAMICS, AND IMMUNOGENICITY OF RAY121 IN HEALTHY VOLUNTEERS
Protocol code: RAY104CT
Sponsor: Chugai Pharmaceutical Co. Ltd. (Pharmaceutical company). Phase: Human Pharmacology (Phase I)- Other. Countries: Netherlands (ended).
Therapeutic area(s): Diseases [C] - Nervous System Diseases [C10]
Gender: Female, Male. Age: 18-64 years. Enrolment: 36.
Status: Ended. Start date (EU): 2024-12-06. End date (EU): 2026-03-10. Decision date: 2024-12-03. Results received: No. Last updated: 2025-03-26.

Condition(s): Nervous System disease

Source: https://euclinicaltrials.eu/ctis-public/view/2024-515151-38-00